EU clinical trial 2024-512730-15-00: A Multi-center, Randomized Parallel Group, Placebo-Controlled Double-Blind Trial to Evaluate the Safety, Efficacy, and Pharmacokinetics of Belimumab, a Human Monoclonal Anti-BLyS Antibody, Plus Standard Therapy in Pediatric Patients with Systemic Lupus Erythematosus (SLE)
Protocol code: 114055
Sponsor: Glaxosmithkline Research & Development Limited (Pharmaceutical company). Phase: Therapeutic exploratory (Phase II). Countries: Spain (ended).
Therapeutic area(s): Diseases [C] - Immune System Diseases [C20]
Gender: Female, Male. Age: 0-17 years. Enrolment: 6.
Status: Ended. Start date (EU): 2012-09-14. End date (EU): 2025-06-02. End date: 2025-09-30. Decision date: 2024-06-20. Results received: Yes. Last updated: 2024-11-22.

Condition(s): Systemic Lupus Erythematosus
Product: Sodium Chloride Intravenous Infusion (0.9% w/v), BP, Benlysta 400 mg powder for concentrate for solution for infusion.

Primary endpoint: "SLE Responder Index (SRI) response rate at Week 52 which is defined as: I. ≥ 4-point reduction from baseline in SELENA SLEDAI score AND II. No worsening (increase of < 0.30 points from baseline) in Physician's Global Assessment (PGA) AND II. No new British Isles Lupus Assessment Group (BILAG) A organ domain score or 2 new BILAG B organ domain scores compared with baseline."
Endpoint(s): "Proportion of subjects meeting PRINTO/ACR Juvenile SLE response evaluation criteria for improvement in juvenile SLE defined as at least 50% improvement in 2 of 5 endpoints (at week 52) below and no more than 1 of the remaining worsening by more than 30%: I. Percent change in Parent's Global Assessment II. Percent change from baseline in PGA III. Percent change from baseline in SELENA SLEDAI score IV. Percent change from baseline in Pediatric V. Percent change in 24-hour proteinuria", "Proportion of subjects meeting PRINTO/ACR Juvenile SLE response evaluation criteria for improvement in juvenile SLE defined as at least 30% improvement in 3 of 5 endpoints (at week 52) below and no more than 1 of the remaining worsening by more than 30%: I. Percent change in Parent's Global Assessment II. Percent change from baseline in PGA III. Percent change from baseline in SELENA SLEDAI score IV. Percent change from baseline in Pediatric V. Percent change in 24-hour proteinuria", Percent change from baseline in Parent Global Assessment at week 52, Percent change from baseline in PGA at week 52, Percent change from baseline in SELENA SLEDAI at week 52, Percent change from baseline in PedsQL Physical Functioning Domain Score at Week 52, Percent change from baseline in proteinuria at Week 52, Proportion of subjects with a sustained SRI response, Proportion of subjects with a sustained Parent Global Assessment response, Safety of belimumab, Observed serum concentrations of belimumab, PK comparison with adult PK, Quality of life evaluated using Pediatric Quality of Life Inventory - Generic Core (PedsQL-GC) and PedsQL Multidimensional Fatigue Scale (PedsQL - Fatigue), evaluation of biological markers

Source: https://euclinicaltrials.eu/ctis-public/view/2024-512730-15-00